EU clinical trial 2024-518307-22-01: A prospective, randomized, double-blind, placebo-controlled Phase I/IIa Clinical Trial to demonstrate the safety and efficacy of DUOFAG® in bacterial infection treatment in patients with surgical wounds
Protocol code: DUO2022_01
Sponsor: MB PHARMA s.r.o. (Pharmaceutical company). Phase: Phase I and Phase II (Integrated)- First administration to humans. Countries: Czechia (authorised, recruitment pending).
Therapeutic area(s): Diseases [C] - Skin and Connective Tissue Diseases [C17]; Diseases [C] - Bacterial Infections and Mycoses [C01]
Gender: Female, Male. Age: 18-64 years, 65+ years. Enrolment: 52.
Status: Authorised, recruitment pending. Decision date: 2024-12-05. Results received: No. Last updated: 2025-10-15.

Condition(s): Surgical wound infection/dehiscence caused by S. aureus and/or P. aeruginosa colonization
Product: Chlorid sodný B. Braun 0,9 % infuzní roztok, DUOFAG

Primary endpoint: For Cohort 1: The endpoint will be the frequency of all (local and systemic) reactions with suspected or confirmed relation to IMP., For pooled Cohorts 1 & 2: Time to commencement of healing. The commencement of healing is defined as the composite measure when both the following conditions must be true: the granulation process in the wound has started, as indicated by the score ≤ 2 in each of the 3 items A8 – A10 of the mLUMT scale, the S. aureus and/or P. aeruginosa infection has been eradicated, i.e., the swab sample is negative on both S. aureus and P. aeruginosa.
Endpoint(s): Safety endpoints: The frequency of the following symptoms following the IMP application will be evaluated: • local reactions (local rash onset, local sensations, worsening of local inflammatory signs, discharge) • systemic reactions (vital signs reactions, fever, rash, arthralgia, gastrointestinal symptoms)., Microbiological endpoints: Change of the microbiological profile of the wound assessed by swab (maximum 8 assessment points)., Clinical efficacy endpoints: mLUMT total score change since Baseline; Time since the start of the study treatment until the bacterial infection eradication – i. e. the swab sample is negative on S. aureus and/or P. aeruginosa; Time since the start of the study treatment until the granulation process in the wound has started, as indicated by the score ≤ 2 in all 3 items A8 – A10 of the mLUMT scale; Time since the start of the study treatment until the wound is closed as assessed by Investigator.

Source: https://euclinicaltrials.eu/ctis-public/view/2024-518307-22-01